EU clinical trial 2025-522767-15-00: HOVON 181 AML: Bleximenib or Placebo in Combination with Standard Induction and Consolidation Therapy followed by Maintenance for the Treatment of Patients with Newly Diagnosed KMT2A-rearranged or NPM1-mutant Acute Myeloid Leukemia Eligible for Intensive Chemotherapy: a double-blind phase 3 study
Protocol code: HOVON 181 AML
Sponsor: Hemato-Oncologie voor Volwassenen Nederland (Hovon) Stichting (Patient organisation/association). Phase: Therapeutic confirmatory (Phase III). Countries: Belgium (ongoing, recruiting), Netherlands (ongoing, recruiting), Germany (ongoing, recruiting), Austria (authorised, recruitment pending), Denmark (authorised, recruitment pending), Estonia (authorised, recruiting), Finland (authorised, recruiting), Ireland (authorised, recruitment pending), Italy (authorised, recruitment pending), Lithuania (authorised, recruitment pending), Spain (authorised, recruitment pending), Sweden (authorised, recruiting), Norway (authorised, recruitment pending), Poland (authorised, recruitment pending).
Therapeutic area(s): Diseases [C] - Neoplasms [C04]
Gender: Female, Male. Age: 18-64 years, 65+ years. Enrolment: 423.
Start date (EU): 2026-01-27. Decision date: 2026-01-15. Results received: No. Last updated: 2026-06-17.
Decision dates by country: AT: 2026-01-18, DK: 2026-04-08, EE: 2026-04-22, FI: 2026-04-13, IE: 2026-04-24, LT: 2026-04-20, ES: 2026-04-24, SE: 2026-04-22, NO: 2026-03-24, PL: 2026-04-23, BE: 2026-01-15, NL: 2026-01-15, DE: 2026-02-27, IT: 2026-04-02

Condition(s): Acute Myeloid Leukemia
Product: placebo to match bleximenib 100 mg, JNJ-75276617, JNJ-75276617, Placebo to match bleximenib 50 mg

Primary endpoint: EFS, defined as the time from randomization to failure to achieve CR after remission induction, hematologic relapse after achieving CR, or death, whichever occurs first.

Source: https://euclinicaltrials.eu/ctis-public/view/2025-522767-15-00